EU clinical trial 2023-508304-38-00: A Phase 2, Randomized, Double-Blind, Placebo-Controlled, Multicenter, Dose-Ranging Study Evaluating the Efficacy and Safety of GS-1427 in Adult Participants With Moderately to Severely Active Ulcerative Colitis (UC)
Protocol code: GS-US-409-5704
Sponsor: Gilead Sciences Inc. (Pharmaceutical company). Phase: Therapeutic exploratory (Phase II). Countries: Spain (ongoing, recruitment ended), Romania (ongoing, recruitment ended), France (ongoing, recruitment ended), Italy (ongoing, recruitment ended), Czechia (ongoing, recruitment ended), Poland (ongoing, recruitment ended), Germany (ongoing, recruitment ended), Belgium (ended), Hungary (ended), Austria (ongoing, recruitment ended).
Therapeutic area(s): Diseases [C] - Digestive System Diseases [C06]
Gender: Female, Male. Age: 18-64 years, 65+ years. Enrolment: 112.
Start date (EU): 2024-09-10. Decision date: 2024-07-22. Results received: No. Last updated: 2026-05-19.
Decision dates by country: BE: 2024-07-24, HU: 2024-07-22, RO: 2024-07-24, ES: 2024-07-22, AT: 2024-07-23, PL: 2024-07-23, FR: 2024-07-22, CZ: 2024-07-24, IT: 2024-07-24, DE: 2024-07-23

Condition(s): Ulcerative Colitis (UC)
Product: PTM 75 mg; Tablets, GS-1427, GS-1427, PTM 100 mg; Tablets, GS-1427, PTM 25 mg; Tablets

Primary endpoint: Clinical response at Week 12 Clinical response is defined as a decrease from baseline in the modified Mayo Clinic Score (mMCS) of ≥ 2 points and at least a 30% reduction from baseline, and a decrease in rectal bleeding subscore of ≥ 1 from baseline or an absolute rectal bleeding subscore of 0 or 1.
Endpoint(s): Incidence of treatment-emergent adverse events, serious adverse events, or deaths, and treatment-emergent laboratory abnormalities, Clinical remission at Week 12, Clinical remission at Week 52 Clinical remission is defined as an mMCS of ≤ 2 points, including a stool frequency subscore (SFS) ≤ 1 and not greater than baseline, rectal bleeding subscore of 0, and centrally-read endoscopic subscore ≤ 1 (score of 1 modified to exclude friability)., Histologic-endoscopic mucosal improvement at Week 12 Histologic-endoscopic mucosal improvement is defined as a Geboes score ≤ 3.1 and endoscopic subscore of ≤ 1., Mucosal healing at Week 12 Mucosal healing is defined as a Geboes score ≤ 2B.1 and endoscopic subscore ≤ 1., Endoscopic improvement at Week 12 Endoscopic improvement is defined as an endoscopic subscore ≤ 1., Partial mMCS remission at Week 52 Partial mMCS remission is defined as a SFS ≤ 1 and rectal bleeding subscore of 0.

Source: https://euclinicaltrials.eu/ctis-public/view/2023-508304-38-00